EU clinical trial 2023-507111-35-00: An open-label, two-part, phase 2 clinical trial to investigate the safety and diagnostic performance of uPAR PET imaging for non-invasive classification of ISUP grades among patients with localised, untreated prostate cancer.
Protocol code: 64Cu-DOTA-AE105-101
Sponsor: Curasight A/S (Pharmaceutical company). Phase: Phase I and Phase II (Integrated)- Other. Countries: Sweden (ongoing, recruiting), Germany (ongoing, recruiting), Denmark (ongoing, recruiting).
Therapeutic area(s): Analytical, Diagnostic and Therapeutic Techniques and Equipment [E] - Diagnosis [E01]
Gender: Male. Age: 18-64 years, 65+ years. Enrolment: 168.
Status: Ongoing, recruiting. Start date (EU): 2024-06-03. Decision date: 2024-04-10. Results received: No. Last updated: 2026-06-12.
Decision dates by country: DK: 2024-04-26, DE: 2024-04-26, SE: 2024-04-26

Condition(s): Prostate Cancer
Product: 64Cu-DOTA-AE105, injection, 64Cu-DOTA-AE105, injection, 64Cu-DOTA-AE105, injection

Primary endpoint: Part 1: SUVmax at 30, 60, and 120-min. post-injection, Part 2: SUVmax in PET acquisitions at 60 min p.i. of 200 MBq.
Endpoint(s): Part 1: SUVmax in PET acquisitions at 60 min post-injection on days 1 and 8., Part 1: Evaluate PK parameters Cmax, Tmax, AUC, Vd, clearance, T1/2 from periodic radioactive counts from whole blood plus the elimination of 64Cu DOTA AE105 into a pooled urine sample to determine activity per mL which will be extrapolated to the mass dose (pg/mL) of IMP., Part 1: SUVmax in PET acquisitions at 30, 60 and 120 min p.i., Part 1: Tumour visibility (numerical rating scale [NRS], 0–2 rating) in PET acquisitions at 30, 60 and 120 min p.i., Part 1: a) SUVmax centred around 60 min p.i. with reconstructions of 3-, 5-, 10-, 20-, 30-, and 40-min frame durations in the 200 MBq cohort. b) Tumour visibility (NRS 0–2 rating) centred around 60 min p.i. with reconstructions of 3-, 5-, 10-, 20-, 30, and 40-min frame durations in the 200 MBq cohort., Part 2: SUVmax in PET acquisitions at 60 min p.i., Part 2: Tumour visibility (NRS 0–2 rating) in PET acquisitions at 60 min p.i., Part 2: SUVmax in PET acquisitions at 60 min p.i., Part 2: Tumour visibility (NRS 0–2 rating) in PET acquisitions at 60 min p.i.

Source: https://euclinicaltrials.eu/ctis-public/view/2023-507111-35-00